EU clinical trial 2025-521524-30-00: A study to assess the safety of ARGX-121 in Healthy Adult Participants
Protocol code: ARGX-121-2401
Sponsor: Argenx (Pharmaceutical company). Phase: Human Pharmacology (Phase I)- First administration to humans. Countries: Netherlands (ended).
Therapeutic area(s): Diseases [C] - Immune System Diseases [C20]
Gender: Female, Male. Age: 18-64 years, 65+ years. Enrolment: 120.
Status: Ended. Start date (EU): 2025-06-05. End date (EU): 2026-02-05. Decision date: 2025-05-30. Results received: No. Last updated: 2025-05-30.

Condition(s): Healthy volunteers

Source: https://euclinicaltrials.eu/ctis-public/view/2025-521524-30-00